EU clinical trial 2022-501004-10-00: A DOUBLE-BLIND, RANDOMIZED, PLACEBO CONTROLLED TRIAL TO ASSESS SAFETY AND EFFICACY OF SLS-005 (TREHALOSE INJECTION, 90.5 MG/ML FOR INTRAVENOUS INFUSION) FOR THE TREATMENT OF ADULTS WITH SPINOCEREBELLAR ATAXIA
Protocol code: SLS-005-302
Sponsor: Seelos Therapeutics Inc. (Industry). Phase: Phase II and Phase III (Integrated). Countries: Spain (ended), Portugal (ended), Germany (ended).
Therapeutic area(s): Diseases [C] - Nervous System Diseases [C10]
Gender: Female, Male. Age: 18-64 years, 65+ years. Enrolment: 58.
Status: Ended. Start date (EU): 2023-01-30. End date (EU): 2024-02-12. Decision date: 2022-12-13. Results received: No. Last updated: 2023-03-10.
Decision dates by country: ES: 2022-12-19, DE: 2022-12-19, PT: 2022-12-13

Condition(s): Spinocerebellar Ataxia type-3 (SCA3)
Product: SLS-005, Trehalose Injection Placebo, Sodium chloride 0,9%, Solution for infusion, SLS-005 Placebo, SUB39441

Primary endpoint: Change from baseline in m-SARA total score at Week 52 in participants with SCA3 treated with SLS-005 0.75 g/kg compared to placebo
Endpoint(s): Key Secondary Endpoints In participants treated with SLS-005 0.75 g/kg: • Change from baseline in Clinical Global Impression of Severity (CGI-S) at Week 52, • Change from baseline in Patient Global Impression of Severity (PGI-S) at Week 52, • Change from baseline in Friedreich’s Ataxia Rating Scale – Activities of Daily Living (FARS-ADL) score at Week 52, • Change from baseline in m-SARA total score at Week 26, Secondary Endpoints In participants with treated with SLS-005 0.75 g/kg: • Changes from baseline in m-SARA total score at Weeks 4, 13, and 39, • Changes from baseline in CGI-S at Weeks 4, 13, 26, and 39, • Changes from baseline in PGI-S at Weeks 4, 13, 26, and 39, • Changes from baseline in FARS-ADL score at Weeks 4, 13, 26, and 39, • Changes from baseline in scores for each item of the m-SARA at Weeks 4, 13, 26, 39, and 52, In all participants: • Incidences of treatment-emergent adverse events (TEAEs) and SAEs, including clinically significant laboratory and ECG abnormalities

Source: https://euclinicaltrials.eu/ctis-public/view/2022-501004-10-00